EU clinical trial 2024-512474-98-00: A Phase 3 Multicenter, Open-label, Randomized Study of ASP2215 (Gilteritinib), Combination of ASP2215 Plus Azacitidine and Azacitidine Alone in the Treatment of Newly Diagnosed Acute Myeloid Leukemia with FLT3 Mutation in Patients Not Eligible for Intensive Induction Chemotherapy
Protocol code: 2215-CL-0201
Sponsor: Astellas Pharma Global Development Inc. (Pharmaceutical company). Phase: Therapeutic confirmatory (Phase III). Countries: Germany (ended), Belgium (ended).
Therapeutic area(s): Diseases [C] - Neoplasms [C04]
Gender: Female, Male. Age: 18-64 years, 65+ years. Enrolment: 63.
Status: Ended. Start date (EU): 2016-11-07. End date (EU): 2024-10-16. End date: 2024-12-18. Decision date: 2024-06-12. Results received: Yes. Last updated: 2024-06-12.
Decision dates by country: BE: 2024-06-12, DE: 2024-06-12

Condition(s): Newly Diagnosed Acute Myeloid Leukemia with FLT3 Mutation in Patients Not Eligible for Intensive Induction Chemotherapy
Product: Vidaza 25 mg/ml powder for suspension for injection, Gilteritinib

Primary endpoint: Primary Efficacy Endpoint: ● Overall Survival (OS)
Endpoint(s): Key Secondary Efficacy Endpoint: ● Event-free survival (EFS), Secondary Efficacy Endpoints: ● Best Response ● CR, CRc, CRh, CR/CRh ● Transfusion conversion rate; transfusion maintenance rate ● Leukemia-free survival (LFS) ● Duration of remission ● Patient-reported fatigue from BFI, Safety Endpoints: ● AEs ● Clinical laboratory (serum chemistry, hematology, coagulation and urinalysis) results ● Physical examinations ● Vital sign measurements ● ECGs ● ECOG performance scores

Source: https://euclinicaltrials.eu/ctis-public/view/2024-512474-98-00